EU clinical trial 2022-503126-12-01: A phase 3 multicenter, randomized, placebo-controlled, double‑blind study to evaluate the efficacy and safety of eneboparatide (AZP‑3601), a parathyroid hormone receptor agonist, in patients with chronic hypoparathyroidism (CALYPSO)
Protocol code: AZP-3601-CLI-002
Sponsor: Alexion Pharmaceuticals Inc. (Pharmaceutical company). Phase: Therapeutic confirmatory (Phase III). Countries: Italy (ongoing, recruitment ended), Netherlands (ongoing, recruitment ended), Denmark (ongoing, recruitment ended), Belgium (ended), France (ongoing, recruitment ended), Germany (ongoing, recruitment ended), Poland (ongoing, recruitment ended), Spain (ongoing, recruitment ended), Hungary (ongoing, recruitment ended), Portugal (ongoing, recruitment ended).
Therapeutic area(s): Diseases [C] - Hormonal diseases [C19]
Gender: Female, Male. Age: 18-64 years, 65+ years. Enrolment: 112.
Start date (EU): 2024-01-05. Decision date: 2023-12-18. Results received: No. Last updated: 2026-08-03.
Decision dates by country: BE: 2023-12-19, NL: 2023-12-18, HU: 2023-12-20, ES: 2024-01-08, DE: 2023-12-20, PT: 2023-12-21, DK: 2023-12-19, PL: 2023-12-21, IT: 2023-12-18, FR: 2024-01-04

Condition(s): Hypoparathyroidism
Product: CALCIUM ARROW 500 mg, comprimé à sucer, Placebo for AZP-3601 Pen A and Pen B, ROCALTROL 0,25 microgramme, capsule molle, UN-ALFA 0,50 microgramme, capsule molle, Eneboparatide, Eneboparatide

Primary endpoint: (MT)-Efficacy: After 24 weeks of treatment, the proportion of patients in the eneboparatide treatment group vs. placebo: •Achieving complete independence from active vitamin D; •Achieving independence from therapeutic doses of oral calcium (i.e., taking oral elemental calcium supplements ≤600 mg/day); and •With albumin-adjusted serum calcium within the normal range (8.3 to 10.6 mg/dL).
Endpoint(s): (MT)-Key secondary efficacy endpoint 1 - At week 24, the proportion of patients in the eneboparatide treatment group vs. placebo who had hypercalciuria at baseline and normalize their 24 hour urinary calcium excretion level (i.e. achieve <250 mg/24 hours for females or <300 mg/24 hours for males);, (MT)-Key secondary efficacy endpoint 2 - At week 24, change from baseline in patient’s symptoms, as assessed by the average weekly HPT DD-SE core physical symptoms scale in the eneboparatide treatment group vs. placebo;, (MT)-Key secondary efficacy endpoint 3 - At week 24, change from baseline in the HPT-LIQ Physical Functioning domain score, in the eneboparatide treatment group vs. placebo;, (MT)-Key secondary efficacy endpoint 4 - At week 24, change from baseline in the SF-36 Physical Functioning subscore in the eneboparatide treatment group vs. placebo., (MT)-Additional secondary endpoint at Week 24: The proportion of patients meeting each component during the fixed dose period: o Independence from active vitamin D; o Independence from therapeutic doses of oral calcium (i.e. taking oral elemental calcium supplements ≤600 mg/day); o Albumin-adjusted serum calcium within the normal range (8.3 to 10.6 mg/dL)., (MT)-Additional secondary endpoint: Change from baseline in urinary calcium (24-hour collection) at Week 24, (MT)-Additional secondary endpoint: Change from baseline in urinary calcium (24-hour collection) at Week 24 for patients who had hypercalciuria at baseline

Source: https://euclinicaltrials.eu/ctis-public/view/2022-503126-12-01